EU clinical trial 2023-503785-22-00: A Phase 3, randomized, double-blind, double-dummy, multicenter, multinational study to assess the efficacy and safety of orally administered tebipenem pivoxil hydrobromide (TBP-PI-HBr) compared to intravenously (IV) administered imipenem-cilastatin in patients with complicated urinary tract infection (cUTI) or acute pyelonephritis (AP)
Protocol code: SPR994-305
Sponsor: Spero Therapeutics Inc. (Pharmaceutical company). Phase: Therapeutic confirmatory (Phase III). Countries: Latvia (ended), Poland (ended), Estonia (ended), Greece (ended), Slovakia (ended), Bulgaria (ended), Romania (ended), Hungary (ended), Croatia (ended).
Therapeutic area(s): Diseases [C] - Bacterial Infections and Mycoses [C01]
Gender: Female, Male. Age: 18-64 years, 65+ years. Enrolment: 1454.
Status: Ended. Start date (EU): 2024-03-25. End date (EU): 2025-05-28. End date: 2025-05-29. Decision date: 2024-02-19. Results received: Yes. Last updated: 2025-06-09.
Decision dates by country: RO: 2024-02-22, LV: 2024-02-22, EE: 2024-02-22, HR: 2024-02-22, GR: 2024-02-23, HU: 2024-02-21, SK: 2024-02-19, PL: 2024-02-23, BG: 2024-02-26

Condition(s): complicated urinary tract infection (cUTI) or acute pyelonephritis (AP)
Product: Tebipenem pivoxil, SODIUM CHLORIDE, IMIPENEM AND CILASTATIN, Placebo to match Tebipenem pivoxil, tablet

Primary endpoint: Overall response (combined per-patient clinical cure and favorable microbiological response) at the TOC visit in the micro-ITT Population
Endpoint(s): Overall response at the TOC visit in the ME Population, Overall response at the EOT and LFU visits in the micro-ITT and ME Populations, Clinical response at the EOT, TOC and LFU visits in the micro-ITT, Clinically Evaluable (CE) and ME Populations, Microbiological response at the EOT, TOC and LFU visits in the micro-ITT and ME Populations, Overall, Clinical and Microbiological response at the TOC, EOT and LFU visits in the micro-ITT and ME Populations in patients with drug resistant Enterobacterales, Treatment-emergent AEs (TEAEs) and SAEs and change from Baseline results for clinical laboratory tests, ECGs, and vital sign measurements in the Safety Population, TBP plasma concentration in the TBP PK Population, Exploratory: Clinical response and Microbiological response at Day 5 in the micro-ITT Population, Exploratory: Time (days) to defervescence in patients with a documented fever at Screening or Day 1 in the micro-ITT Population, Exploratory: Occurrence of superinfection and new infection in the micro-ITT Population, Exploratory: TBP or imipenem concentration in urine in the Urine PK Population subgroup, Exploratory: Composite ordinal endpoint (DOOR) at TOC and LFU in the micro-ITT Population

Source: https://euclinicaltrials.eu/ctis-public/view/2023-503785-22-00